EU clinical trial 2022-502841-91-00: I6T-MC-AMAX; A Phase 3, Multicenter, Open-Label, Long-Term Extension Study to Evaluate the Long-Term Efficacy and Safety of Mirikizumab in Patients With Crohn’s Disease
Protocol code: I6T-MC-AMAX
Sponsor: Eli Lilly & Co. (Pharmaceutical company). Phase: Therapeutic confirmatory (Phase III). Countries: Czechia (ongoing, recruitment ended), Lithuania (ongoing, recruitment ended), Romania (ongoing, recruitment ended), Italy (ongoing, recruitment ended), Croatia (ended), France (ongoing, recruitment ended), Latvia (ongoing, recruitment ended), Belgium (ongoing, recruitment ended), Netherlands (ended), Slovakia (ongoing, recruitment ended), Poland (ongoing, recruiting), Hungary (ongoing, recruitment ended), Austria (ongoing, recruitment ended), Germany (ongoing, recruitment ended).
Therapeutic area(s): Diseases [C] - Digestive System Diseases [C06]
Gender: Female, Male. Age: 18-64 years, 65+ years. Enrolment: 338.
Start date (EU): 2020-08-12. Decision date: 2024-06-19. Results received: No. Last updated: 2026-06-19.
Decision dates by country: IT: 2024-07-02, DE: 2024-06-25, LV: 2024-09-17, BE: 2024-06-19, NL: 2024-06-19, PL: 2024-07-17, FR: 2024-06-24, HU: 2024-06-20, AT: 2024-06-24, HR: 2024-06-19, RO: 2024-06-20, LT: 2024-07-19, SK: 2024-06-24, CZ: 2024-06-20

Condition(s): Crohn’s Disease
Product: Mirikizumab, Mirikizumab, Mirikizumab

Primary endpoint: Percentage of Participants Achieving Endoscopic Response (Endoscopic response based on Simple Endoscopic Score for Crohn’s Disease (SES-CD) total score) [Time Frame: Week 52], Percentage of Participants Achieving Clinical Remission (Clinical remission based on CDAI) [Time Frame: Week 52]

Source: https://euclinicaltrials.eu/ctis-public/view/2022-502841-91-00